EU clinical trial 2023-503952-28-00: A Randomised, Open label, Controlled, Multicentre, Phase 2 Trial of First line Treatment with Mesenchymal Stromal Cells MC0518 Versus Best Available Therapy in Paediatric Participants with Steroid refractory Acute Graft versus host Disease After Allogeneic Stem Cell Transplantation (BALDER Trial)
Protocol code: MC MSC.2/aGvHD
Sponsor: Medac Gesellschaft fuer klinische Spezialprapaerate mbH (Pharmaceutical company). Phase: Therapeutic exploratory (Phase II). Countries: France (ongoing, recruitment ended), Spain (ongoing, recruitment ended), Germany (ongoing, recruitment ended), Poland (ended), Italy (ongoing, recruitment ended).
Therapeutic area(s): Diseases [C] - Immune System Diseases [C20]
Gender: Female, Male. Age: 0-17 years. Enrolment: 54.
Start date (EU): 2023-11-13. Decision date: 2023-09-08. Results received: No. Last updated: 2026-06-03.
Decision dates by country: IT: 2024-05-13, PL: 2023-09-13, FR: 2023-09-12, ES: 2023-09-12, DE: 2023-09-08

Condition(s): Steroid refractory Acute Graft versus host Disease
Product: ETANERCEPT, METHOXSALEN, ANTITHYMOCYTE IMMUNOGLOBULIN (RABBIT), RUXOLITINIB, INFLIXIMAB, MC0518

Primary endpoint: Overall response (OR), defined as complete response (CR) or partial response (PR) at Visit Day 28 relative to the aGvHD status at baseline (Visit Day 1 prior to the first treatment).
Endpoint(s): Freedom from treatment failure until 6 months (Visit Day 180), defined as the time from the date of randomisation to the date of the event. An event is defined as death, relapse or progression of the underlying disease, or addition of or change to any further systemic aGvHD therapy (except changes in steroid treatment). The diagnosis of cGvHD is a competing event, OS until Visit Month 24, defined as the time from the date of randomisation to the date of death due to any cause, aGvHD response at Visit Day 28 assessed by CR, PR, and NR and at Visit Day 60, Visit Day 100, and Visit Day 180 assessed by OR, CR, PR, and NR relative to baseline, Change of aGvHD grade at Visit Day 8, Visit Day 15, Visit Day 22, Visit Day 28, Visit Day 60, Visit Day 100, and Visit Day 180 relative to baseline, Time to response, defined as the time from the date of the first treatment administration to the date of the first response (CR or PR), Duration of response until Visit Month 24, defined as the time from the date of the first OR (CR or PR) to the date of aGvHD assessed as NR compared to the baseline assessment, or the date of addition of or change to any further systemic aGvHD therapy (except changes in steroid treatment), in responders, Best OR until Visit Day 28, defined as the achievement of an OR at any time point up to and including Visit Day 28, Cumulative dose of steroids given for SR-aGvHD per kg body weight (BW) from the date of the first treatment administration until Visit Day 28, Visit Day 60, and until Visit Month 24, Incidence of and time to cGvHD from Visit Day 60 until Visit Month 24, Incidence of graft failure (GF) from baseline until Visit Month 24, Incidence of and time to relapse or progression of the underlying disease in participants with underlying malignant disease from randomisation until Visit Month 24, Event free survival until Visit Month 24, defined as the time from the date of randomisation to the date of the event. An event is defined as GF, relapse or progression of the underlying disease, or death due to any cause, Non-relapse mortality until Visit Month 24, defined as the time from the date of randomisation to the date of the event. An event is defined as death without previous relapse or progression of the underlying disease. Relapse or progression are competing events, The incidence and severity of all adverse events (AEs), including viral, bacterial, and fungal infections until Visit Day 60, and of adverse reactions (ARs) until Visit Month 24, Performance score (Karnofsky / Lansky scale) at Visit Day 8, Visit Day 15, Visit Day 22, Visit Day 28, Visit Day 60, and Visit Day 100 compared to baseline, HRQoL measures: Paediatric Quality of Life InventoryTM (PedsQL™) 4.0 Generic Core Scales with the PedsQL™ Stem Cell Transplant Module at Visit Day 28, Visit Day 60, Visit Day 100, and Visit Day 180 compared to baseline

Source: https://euclinicaltrials.eu/ctis-public/view/2023-503952-28-00